EU clinical trial 2024-514264-42-00: EDULOX 2- Patientundervisning og medicinsk behandling (duloxetin/aktiv placebo) til patienter med svær funktionel lidelse: et randomiseret, kontrolleret forsøg.
Sponsor: Region Midtjylland (Hospital/Clinic/Other health care facility). Phase: Therapeutic use (Phase IV). Countries: Denmark (ongoing, recruiting).
Therapeutic area(s): Diseases [C] - Pathological Conditions, Signs and Symptoms [C23]
Gender: Female, Male. Age: 18-64 years. Enrolment: 212.
Status: Ongoing, recruiting. Start date (EU): 2024-02-09. Decision date: 2024-09-13. Results received: No. Last updated: 2025-04-30.

Condition(s): Functional Somatic disorder
Product: Cymbalta 30 mg hard gastro-resistant capsules, Placebo tbl 6mm see below, BENZTROPINE MESYLATE, Duloxetin Krka 30 mg enterokapsel, hard

Primary endpoint: Forskel i patientvurderet helbredsrelateret livskvalitet og funktionsevne målt ved en SF-36 aggregatscore, der inkluderer underskalaerne "fysisk funktion", "kropssmerter" og "vitalitet" ved endpoint T3 (uge 12). Dette outcome måler fysiske domæner, der normalt påvirkes i multiorgan BDS (Rief et al., 2017; Schröder, Oernboel, et al., 2012; Schröder, Rehfeld, et al., 2012)., 2. Forskel i patientvurderet samlet helbredsforbedring målt ved 5-punkts klinisk global forbedringsskala (CGI) ved slutpunktet T3 (uge 12). Patienter bedømmer deres generelle helbred som "meget dårligere", "værre", "uændret", "bedre" eller "meget bedre" som svar på følgende spørgsmål: "Hvordan betragter du din helbredstilstand nu, sammenlignet med da du først kom til afdelingen?"
Endpoint(s): Forskel mellem grupper ved endpoint (T3) i: - Symptomer på BDS målt ved hjælp af BDS-tjeklisten (Budtz-Lilly, Fink, et al., 2015) - Somatiseringsscoren af SCL-92, som er den danske version af symptom checklist SCL-90 (SCL-92, (Olsen et al., 2004) - Symptomer på angst og depression målt ved relevante subscores af symptomtjeklisten (SCL-92 (Olsen et al., 2004), Forskel ved grupperne T3: - Symptomintensitet, symptominterferens og smerteintensitet målt på en numerisk rangskala (NRS, 0-10) (Rief et al., 2017) - Sygdomsbekymring målt ved Whiteley-6-R (Carstensen et al., 2020; Fink et al., 1999) - Fysisk, mental og social velbefindende målt ved relevante underskalaer af Short-Form 36 Health Survey (SF-36) og komponentsammendragene (Bjorner et al., 1998) (behandlingsspecifikke mål), Forskel i grupperne ved T3; - Sygdomsopfattelse målt ved Brief-IPQ (Broadbent et al., 2006) - Sygdomsadfærd målt ved BRIQ (Spence et al., 2005) - Kognitiv funktion målt ved Cognitive Failures Questionnaire (CFQ) (Broadbent et al., 1982), Forskel mellem grupperne T3: - Oplevet mening i livet skalaen målt ved The Sources of Meaning and Meaning in Life, dansk version) (SoMe-Da) (Pedersen et al., 2018) - Tanker og følelser om kroniske smerter PE-BPM, Forskel mellem grupper ved endpoint (T3) i: - Klinikervurderet forbedring målt ved 5-punkts CGI-skala. Klinikken bedømmer patienternes generelle helbred som "meget værre", "værre", "uændret", "bedre" eller "meget bedre" som svar på følgende spørgsmål: "Sammenlignet med før patienten påbegyndte behandlingen på Funktionelle Lidelser, hvordan vil du i dag beskrive patientens helbredstilstand?" - Klinikers vurdering af biopsykosocial bevidsthed og parathed til at ændre sig, Forskel mellem grupperne ved T3: - Diagnostisk revurdering (bilag 30) (Rief et al., 2017). - Hændelser og bivirkninger. Dette sker ved alle forsøgsdeltagerkontakter, og hvis deltageren kontakter afdelingen., - Patienternes forventninger til behandlingseffekter (forsøgsmedicinen og patientuddannelsen) og målt ved troværdighed/forventningsspørgeskemaet (CEQ) (bilag 31) før randomiseringen (T1) (Devilly & Borkovec, 2000)., - Patienternes forventet effekt af forsøgsmedicinen på deres samlede velbefindende (NRS, 0-10) (bilag 32) før randomiseringen (T1), - Oplevede eksistentielle og åndelige behov SNQ (Bilag 33) før randomiseringen (T1)., - Forhold mellem patienter og klinikere målt ved Working Alliance Inventory-Short revideret (WAI-SR) (bilag 34) ved endpoint (T3) (Munder et al., 2010)., - Negative effekter af psykoterapi målt ved Inventory for Assessment of Negative Effects of Psychotherapy (INEP- bilag 35) ved 3-måneders opfølgning (T4) (Holsting et al., 2017)., - Patienters erindring om det pædagogiske indhold (bilag 36) ved endpoint (T3)., - Tilfredsheden med behandlingen Experience of Service Questionnaire (ESQ) (Bilag 46) ved endpoint (T3)., - Sundhedsøkonomiske tiltag: Europæisk livskvalitet - 5 dimensioner (EQ-D5- bilag 37) og data fra danske nationale registre (brug af sundhedspleje (primær- og sekundærplejebesøg), sygefravær og sociale ydelser, recepter) ved opstart (T1) og 1 og 2 års opfølgning (T5 og T6) (Erlangsen & Fedyszyn, 2015; Rabin & de Charro, 2001).

Source: https://euclinicaltrials.eu/ctis-public/view/2024-514264-42-00